EU clinical trial 2023-506253-38-00: H8H-MC-LAHV: Pediatric Options for Migraine Relief: A Randomized, Double-Blind, Placebo-Controlled Study of Lasmiditan for Acute Treatment of Migraine: PIONEER-PEDS1
Protocol code: H8H-MC-LAHV
Sponsor: Eli Lilly & Co. (Pharmaceutical company). Phase: Therapeutic confirmatory (Phase III). Countries: Netherlands (ended), Germany (ended), Spain (ended), Belgium (ended), Romania (ended), Italy (ended), France (ended).
Therapeutic area(s): Diseases [C] - Nervous System Diseases [C10]
Gender: Female, Male. Age: 0-17 years. Enrolment: 205.
Status: Ended. Start date (EU): 2020-11-09. End date (EU): 2025-09-30. End date: 2025-11-12. Decision date: 2024-03-22. Results received: Yes. Last updated: 2025-04-03.
Decision dates by country: FR: 2024-03-22, RO: 2024-04-09, ES: 2024-03-22, DE: 2024-03-25, IT: 2024-03-25, BE: 2024-04-02, NL: 2024-03-25

Condition(s): Migraine
Product: Placebo to match 100mg tablet, Lasmiditan, LASMIDITAN, Placebo to match 50mg tablet, LASMIDITAN, Placebo to match 100mg film coated tablet, Lasmiditan, Placebo to match 25mg tablet, Lasmitidan, Placebo to match 50mg film coated tablet

Primary endpoint: Percentage of Participants with Pain Freedom (High Dose)

Source: https://euclinicaltrials.eu/ctis-public/view/2023-506253-38-00